EU clinical trial 2024-514828-16-00: Double-blind randomized acetazolamide trial in normal pressure hydrocephalus (DRAIN)
Protocol code: NPH-01
Sponsor: Region Uppsala (Hospital/Clinic/Other health care facility). Phase: Therapeutic exploratory (Phase II). Countries: Sweden (ended).
Therapeutic area(s): Diseases [C] - Nervous System Diseases [C10]
Gender: Female, Male. Age: 18-64 years, 65+ years. Enrolment: 56.
Status: Ended. Start date (EU): 2025-09-25. End date (EU): 2026-04-21. Decision date: 2024-10-25. Results received: No. Last updated: 2024-10-25.

Condition(s): Normal pressure hydrocephalus
Product: The Placebo is a Size 00el capsule shell with a Microcrystalline Cellulose fill. Please see Simplified IMPD for detailed information., ACETAZOLAMIDE

Primary endpoint: The relative change in gait between walking trials is the primary outcome measure. Walking is examined as the sum of time and steps required to walk a distance of 10 meters, timed up-and-go (TUG), and walking backwards for 3 meters
Endpoint(s): Quality of life assessed by the EQ-5D-5L self-completion questionnaire and questionnaires 1-2 that estimate the patient's own experience of symptoms and side effects, respectively, The volume of periventricular white matter calculated by volumetric analysis of brain MRI, The total symptomatic change in motor skills, cognition, and continence, assessed using the Swedish iNPH scale, Blood and cerebrospinal fluid biomarkers (neurofilament light chain protein (NFL), amyloid-beta-42, Tau, and glial fibrillary acidic protein (GFAp))

Source: https://euclinicaltrials.eu/ctis-public/view/2024-514828-16-00